EU clinical trial 2024-518710-11-00: Randomized phase 2 study of Valproic acid combinEd with Simvastatin and gemcitabine/nab-paclitaxel-based regimens in untreated metastatic Pancreatic Adenocarcinoma patients (The VESPA trial)
Protocol code: VESPA
Sponsor: IRCCS Istituto Nazionale Tumori Fondazione Pascale (Hospital/Clinic/Other health care facility). Phase: Therapeutic exploratory (Phase II). Countries: Italy (ongoing, recruiting), Spain (ongoing, recruiting).
Therapeutic area(s): Diseases [C] - Neoplasms [C04]
Gender: Female, Male. Age: 18-64 years, 65+ years. Enrolment: 170.
Status: Ongoing, recruiting. Start date (EU): 2023-06-12. Decision date: 2024-11-15. Results received: No. Last updated: 2026-07-31.
Decision dates by country: ES: 2024-11-15, IT: 2024-11-19

Condition(s): Metastatic pancreatic ductal adenocarcinoma (mPDAC)
Product: VALPROIC ACID, CISPLATIN, Abraxane 5 mg/ml powder for dispersion for infusion., SIMVASTATIN, CAPECITABINE, VALPROIC ACID, GEMCITABINE

Primary endpoint: Progression Free Survival (PFS) between two arms PFS is defined as the time from randomization to the first documentation of objective disease progression by RECIST 1.1 criteria, or death due to any cause, whichever occurs first. PFS will be censored at the time of the last available tumor assessment documenting absence of progressive disease for patients alive at the time of analysis.
Endpoint(s): To compare the two arms in terms of: • Objective Tumor Response Rate (ORR) • Disease Control Rate (DCR) • Duration of Objective response (DOR) • CA19.9 level reduction • Overall survival (OS) • Overall toxicity rate • Quality of life (QoL), To evaluate mechanistically–based pharmacokinetic and pharmacodynamic biomarkers on blood samples., To explore prognostic factors and predictive biomarkers for response and toxicity on blood samples as well as primary tumors and resected metastases when available

Source: https://euclinicaltrials.eu/ctis-public/view/2024-518710-11-00